EU clinical trial 2023-506988-34-00: ATHENA: Effects of ziltivekimab versus placebo on heart failure symptoms and physical function in patients with heart failure with mildly reduced or preserved ejection fraction and systemic inflammation
Protocol code: NN6018-4914
Sponsor: Novo Nordisk A/S (Pharmaceutical company). Phase: Therapeutic confirmatory (Phase III). Countries: Poland (ongoing, recruitment ended), Czechia (ongoing, recruitment ended), Germany (ongoing, recruitment ended), France (ongoing, recruitment ended), Greece (ongoing, recruitment ended), Bulgaria (ongoing, recruitment ended), Spain (ongoing, recruitment ended).
Therapeutic area(s): Diseases [C] - Cardiovascular Diseases [C14]
Gender: Female, Male. Age: 18-64 years, 65+ years. Enrolment: 318.
Status: Ongoing, recruitment ended. Start date (EU): 2024-03-27. Decision date: 2024-03-15. Results received: No. Last updated: 2026-08-03.
Decision dates by country: FR: 2024-03-15, GR: 2024-03-26, PL: 2024-03-25, DE: 2024-03-20, ES: 2024-03-20, CZ: 2024-03-18, BG: 2024-03-25

Condition(s): Heart failure with mildly reduced or preserved ejection fraction and systemic inflammation
Product: ziltivekimab, Placebo (ziltivekimab C)

Primary endpoint: Primary: Change in KCCQ clinical summary score (KCCQ-CSS) from randomisation (month 0) to end-of-treatment (month 12) (Score (score on scale; range; 0-100))
Endpoint(s): Confirmatory secondary: Change in six-minute walk distance (6MWD) from randomisation (month 0) to end-of-treatment (month 12) (Metres), Supportive secondary: Change in hs-CRP from randomisation (month 0) to end-of-treatment (month 12) (Ratio to baseline), Supportive secondary: Participants experiencing improvement in NYHA Class (yes/no) from randomisation (month 0) to end-of-treatment (month 12) (Count of participant), Supportive secondary: Change in NT-proBNP from randomisation (month 0) to end-of-treatment (month 12) (Ratio to baseline), Supportive secondary: Change in eGFR (CKD-EPI) from randomisation (month 0) to end-of-treatment (month 12) (mL/min/1.73 m2), Supportive secondary: Participants achieving threshold for meaningful within- patient change in KCCQ-CSS (yes/no) from randomisation (month 0) to end-of-treatment (month 12) (Count of participants), Supportive secondary: Participants achieving threshold for meaningful within- patient change in 6MWD (yes/no) from randomisation (month 0) to end-of-treatment (month 12) (Count of participants), Supportive secondary: Participants improving 5 points or more in KCCQ-CSS (yes/no) from randomisation (month 0) to end-of-treatment (month 12) (Count of participants), Supportive secondary: Participants improving 10 points or more in KCCQ-CSS (yes/no) from randomisation (month 0) to end-of-treatment (month 12) (Count of participants), Supportive secondary: Change in KCCQ overall summary score (KCCQ-CCS) from randomisation (month 0) to end-of-treatment (month 12) (Score (score on scale; range 0-100)), Supportive secondary: Participants experiencing deterioration in NYHA class (yes/no) from randomisation (month 0) to end-of-treatment (month 12) (Count of participants), Supportive secondary: Change in KCCQ total symptom score from randomisation (month 0) to end-of-treatment (month 12) (Score, range 0-100), Supportive secondary: Change in KCCQ physical limitations score from baseline (month 0) to end-of-treatment (month 12) (Score, range 0-100), Supportive secondary: Change in KCCQ social limitations score from randomisation (month 0) to end-of-treatment (month 12) (Score, range 0-100), Supportive secondary: Change in KCCQ health-related quality of life score from randomisation (month 0) to end-of-treatment (month 12) (Score, range 0-100)

Source: https://euclinicaltrials.eu/ctis-public/view/2023-506988-34-00